EU clinical trial 2024-511158-36-00: A Phase 1b/2, Open-Label, Randomized Platform Study Evaluating the Efficacy and Safety of AB928-Based Treatment Combinations in Patients with Metastatic Colorectal Cancer
Protocol code: ARC-9
Sponsor: Arcus Biosciences Inc. (Pharmaceutical company). Phase: Phase I and Phase II (Integrated)- Other. Countries: France (ended), Italy (ended), Spain (ended).
Therapeutic area(s): Diseases [C] - Neoplasms [C04]
Gender: Female, Male. Age: 18-64 years, 65+ years. Enrolment: 57.
Status: Ended. Start date (EU): 2021-08-05. End date (EU): 2025-06-10. Decision date: 2024-09-30. Results received: No. Last updated: 2025-07-08.
Decision dates by country: FR: 2024-09-30, IT: 2024-10-14, ES: 2024-10-07

Condition(s): Metastatic colorectal cancer
Product: Etrumadenant, Quemliclustat, FLUOROURACIL, BEVACIZUMAB, OXALIPLATIN, CALCIUM FOLINATE, Zimberelimab, Etrumadenant, REGORAFENIB

Primary endpoint: Cohort A and B - Progression-free Survival (PFS) PFS according to Response Evaluation Criteria in Solid Tumors (RECIST) v1.1, as assessed by the Investigator [Time Frame: From randomization until death from any cause (up to approximately 3-7 years)], Cohort C - Objective Response Rate (ORR) ORR according to RECIST v1.1, as assessed by the Investigator [Time Frame: From randomization until death from any cause (up to approximately 3-7 years)], Number of Participants With Treatment-emergent Adverse Events [Time Frame: Up to approximately 10 Months]
Endpoint(s): Cohorts A and B - Objective Response Rate (ORR) ORR according to RECIST v1.1 as assessed by the Investigator [Time Frame: From randomization until death from any cause (up to approximately 3-7 years)], Cohorts A, B, and C- Duration of Disease Response (DoR) DoR according to RECIST v1.1, as assessed by the Investigator [Time Frame: From randomization until death from any cause (up to approximately 3-7 years)], Cohorts A, B, and C- Disease Control Rate (DCR) DCR according to RECIST v1.1, as assessed by the Investigator [Time Frame: From randomization until death from any cause (up to approximately 3-7 years)], Cohorts A and B - Overall Survival (OS) OS according to RECIST v1.1, as assessed by the Investigator [Time Frame: From randomization until death from any cause (up to approximately 3-7 years)], Observed Maximum Concentration (Cmax) of Etrumadenant and its Metabolites Cycle 1 Day 1 and Cycle 2 Day 1 [Time Frame: From randomization until death from any cause (up to approximately 10 months)], Area Under the Plasma Concentration Versus Time Curve From Time Zero to 24 Hours [AUC(0-24)] of Etrumadenant and its Metabolites [Time Frame: Up to 24 hours following Day 1 Cycle 1 and Cycle 2 (each cycle is 28 days)], Trough Concentrations of Etrumadenant and its Metabolites [Time Frame: Multiple timepoints up to approximately 16 months], Cmax End of Infusion (EOI) of AB680 [Time Frame: At the end of infusion on Day 1 Cycle 1 and Cycle 2 (each cycle is 28 days)], Area Under the Plasma Concentration Versus Time Curve From Time Zero to 336 Hours [AUC(0-336)] of AB680 [Time Frame: Up to 336 hours following Day 1 Cycle and Cycle 2 (each cycle is 28 days)]], Trough Concentrations of AB680 [Time Frame: Multiple timepoints up to approximately 16 months], Cmax EOI of Zimberelimab [Time Frame: Multiple timepoints up to approximately 16 months], AUV(0-336) of Zimberelimab [Time Frame: Cycle 1 Day 1 up to 336 hours], Trough Concentrations of Zimberelimab [Time Frame: Multiple timepoints up to approximately 16 months], Number of Participants With Anti-Drug Antibodies to the Biologic Component(s) of Combination Therapy [Time Frame: Up to approximately 10 months]

Source: https://euclinicaltrials.eu/ctis-public/view/2024-511158-36-00